EU clinical trial 2024-514903-33-00: A 4-way randomized double-blinded migration (RSA), bone density (DXA), and biomarker study assessing adaptive bone changes and implant fixation and longevity of the new Regenerex Porous Titanium Tibial Tray with different adjuvant medical therapies.
Sponsor: Region Midtjylland (Hospital/Clinic/Other health care facility). Phase: Therapeutic exploratory (Phase II). Countries: Denmark (ongoing, recruitment ended).
Therapeutic area(s): Diseases [C] - Musculoskeletal Diseases [C05]
Gender: Female, Male. Age: 18-64 years, 65+ years. Enrolment: 107.
Status: Ongoing, recruitment ended. Start date (EU): 2014-01-12. Decision date: 2024-07-10. Results received: No. Last updated: 2025-04-07.

Condition(s): Osteoarthritis in the knee treated with cementless total knee arthroplasty
Product: Zoledronic Acid Fresenius Kabi 4 mg/5 ml koncentrat till infusionsvätska, lösning, SODIUM CHLORIDE, SODIUM CHLORIDE, Prolia 60 mg solution for injection in pre-filled syringe

Primary endpoint: Implant migration (RSA) measured continuously from baseline to followup (MTPM) and estimation of Continuous MTPM (MTPM migration > 0.2 mm between 12 and 24 months of follow-up) according to Ryd et al. (Ryd et al., 1995).
Endpoint(s): DXA - Changes in Bone Mineral Density under the Tibial Tray and in proximity of the central stem., Biomarkers - Bone resorption from baseline to follow-ups and correlation between bone density changes, biomarkers of bone resorption and implant migration

Source: https://euclinicaltrials.eu/ctis-public/view/2024-514903-33-00